EU clinical trial 2024-514179-17-00: A Randomized Phase III Trial of Platinum Chemotherapy plus Paclitaxel with Bevacizumab and Atezolizumab versus Platinum Chemotherapy plus Paclitaxel and Bevacizumab in Metastatic (stage IVB), Persistent, or Recurrent Carcinoma of the Cervix (BEATcc )
Protocol code: BEATcc
Sponsor: Grupo Espanol De Investigacion En Cancer De Ovario (Patient organisation/association). Phase: Therapeutic confirmatory (Phase III). Countries: Italy (ended), Norway (ended), France (ended), Sweden (ended), Germany (ended), Spain (ended).
Therapeutic area(s): Diseases [C] - Neoplasms [C04]
Gender: Female. Age: 18-64 years, 65+ years. Enrolment: 339.
Status: Ended. Start date (EU): 2018-10-02. End date (EU): 2025-08-31. Decision date: 2024-10-23. Results received: No. Last updated: 2026-01-15.
Decision dates by country: FR: 2024-11-22, IT: 2024-10-28, DE: 2024-10-23, SE: 2024-10-23, NO: 2024-10-23, ES: 2024-10-23

Condition(s): Metastatic (stage IVB), Persistent, or Recurrent Carcinoma of the Cervix
Product: Tecentriq 1 200 mg concentrate for solution for infusion, Avastin 25 mg/ml concentrate for solution for infusion.

Primary endpoint: Progression free survival (PFS), Overall Survival (OS)
Endpoint(s): Objective Response Rate (ORR), Duration of response (DOR), Frequency and severity of adverse events, Time from randomization to first subsequent therapy or death (TFST), Time from randomization to second progression (PFS2) based on radiologic assessment, start of a new line of therapy, symptomatic deterioration or death, Mean and mean changes from baseline score in patient function (role, physical) and GHS/HRQoL., Proportion of patients reporting each response option, Utility scores of the EQ-5D-5L questionnaire., Relationship between tumour immune-related or disease type-related biomarkers., Relationship between certain exploratory biomarkers, Relationship between ATB use within 2 months before and 1 month after the first study administration with atezolizumab efficacy as measured by PFS and OS.

Source: https://euclinicaltrials.eu/ctis-public/view/2024-514179-17-00